EU clinical trial 2024-517295-37-00: Prospective multicenter clinical trial for risk estimation and treatment stratification in low and intermediate risk neuroblastoma patients - NB2015-LR
Protocol code: Uni-Koeln-4299
Sponsor: University Of Cologne (Educational Institution). Phase: Therapeutic confirmatory (Phase III). Countries: Germany (authorised, recruitment pending).
Therapeutic area(s): Diseases [C] - Neoplasms [C04]
Gender: Female, Male. Age: 0-17 years, 18-64 years. Enrolment: 280.
Status: Authorised, recruitment pending. Decision date: 2024-10-25. Results received: No. Last updated: 2024-10-25.

Condition(s): low and intermediate risk neuroblastoma
Product: MELPHALAN, DINUTUXIMAB BETA, FILGRASTIM, VINDESINE SULFATE, VINCRISTINE SULFATE, CLONAZEPAM, BUSULFAN, CYCLOPHOSPHAMIDE, ETOPOSIDE, CARBOPLATIN, CYCLOPHOSPHAMIDE, LENOGRASTIM, MESNA, DOXORUBICIN HYDROCHLORIDE, ETOPOSIDE PHOSPHATE, DACARBAZINE, IFOSFAMIDE, CISPLATIN

Primary endpoint: Event-free survival (EFS): Time from diagnosis to event or last follow-up for patients without event; event is defined as death for all reasons, progression and relapse following previous complete remission or secondary malignant disease
Endpoint(s): Overall Survival (OS): Because of the importance for the individual patient OS has been chosen as secondary endpoint., Risk factors to impact on EFS and OS: The risk factors age at diagnosis, stage according to INSS and INRG, and copy number alterations of selected genes have been implemented in the INRG classification. These factors will be assessed by multivariate and subgroup analysis. Moreover, the description of patients’ cohorts by these risk factors is mandatory for international comparison of the trial results., Response: In neuroblastoma, response to trial treatment is not clearly correlated to outcome. In this trial, response to trial treatment will be compared to historical controls, with a special focus to the cohort with reduced treatment (group C)., Regression: The percentage of spontaneous regression will be described in patients where the residual primary is observed without cytotoxic treatment and compared to historical controls., Incidence rates of toxic events: The administered chemotherapy cycles are known to cause treatment related side effects. To estimate the burden for the patients, kind and intensity of side effects will be compared to historical controls and between the patient groups A-C., Additional molecular analysis: The impact of clinical and molecular risk factors such as copy number alterations, telomere maintenance status and mutation status of candidate genes on EFS and OS will be analyzed., Group D, relapsed patients: Outcome of patients with relapse or progression of neuroblastoma diagnosed at the age < 18 months with unfavorable classification.

Source: https://euclinicaltrials.eu/ctis-public/view/2024-517295-37-00